EU clinical trial 2024-515845-40-00: Impact of a treatment with angiotensin receptor blocker on outcome after acute kidney injury in patients discharged from the ICU “START-or-NOT” trial. A prospective, randomized, double blinded, multicenter study
Protocol code: APHP 200040
Sponsor: Assistance Publique Hopitaux De Paris (Hospital/Clinic/Other health care facility). Phase: Therapeutic confirmatory (Phase III). Countries: France (ended).
Therapeutic area(s): Not possible to specify
Gender: Female, Male. Age: 18-64 years, 65+ years. Enrolment: 508.
Status: Ended. Start date (EU): 2022-11-22. End date (EU): 2026-06-25. Decision date: 2024-10-23. Results received: No. Last updated: 2024-10-23.

Condition(s): Acute kidney injury
Product: Placebo IRBESARTAN EG 150 mg, Irbesartan EG 150 mg comprimés pelliculés

Primary endpoint: The primary endpoint of the trial is the time to MACE (major adverse cardiovascular events), i.e. a composite outcome composed of all-cause mortality and all unscheduled hospital readmission for cardiovascular events (acute heart failure, stroke, acute coronary syndrome) during the year following ICU or TCU discharge
Endpoint(s): Albuminuria >0.3 g/day one year after ICU or TCU discharge, Occurrence of chronic kidney disease one year after ICU or TCU discharge defined as eGFR <60 ml/min/1.73m2, Decrease of estimated glomerular filtration from baseline to one year after enrollment, Change in Chronic kidney disease staging one year after enrollment, New episode of acute kidney injury (according to the KDIGO criteria) requiring hospitalization, Hyperkalemia >6 mmol/L, Death, Biological collection built up at inclusion and at the end of the study

Source: https://euclinicaltrials.eu/ctis-public/view/2024-515845-40-00